EU clinical trial 2024-518591-31-00: SGLT2 INHIBITION (DAPAGLIFLOZIN) IN DIABETIC AND NON-DIABETIC HEMODIALYSIS PATIENTS WITH AND WITHOUT RESIDUAL URINE VOLUME: A PROSPECTIVE RANDOMIZED, PLACEBO-CONTROLLED, DOUBLE-BLINDED PHASE II TRIAL
Sponsor: Medical University Of Vienna (Educational Institution). Phase: Therapeutic exploratory (Phase II). Countries: Austria (authorised, recruitment pending).
Therapeutic area(s): Diseases [C] - Cardiovascular Diseases [C14]
Gender: Female, Male. Age: 18-64 years, 65+ years. Enrolment: 220.
Status: Authorised, recruitment pending. Decision date: 2024-12-15. Results received: No. Last updated: 2024-12-15.

Condition(s): Chronic Kidney Disease, Kidney Failure, Left Ventricular Hypertrophy, Hemodialysis
Product: Forxiga 10 mg film-coated tablets, Placebo identical to Forxiga 10mg encapsulated in Gelatinecapsules

Primary endpoint: change in Left Ventricular Mass indexed to body surface area (LVMI [g/m²]) from baseline to 6 months
Endpoint(s): Glucose Insulin C-Peptide Glucagon Glucagon-like Peptide-1 Epinephrine Norepinephrine Cortisol Growth Hormone Lactate Alanine β-hydroxybutyrate (βOHB) HbA1C Left Ventricular Mass (LVM) Left Ventricular Ejection Fraction (EF), Left Ventricular Hypertrophy (LVH) cardiac fibrosis Left Ventricular Mass Index to height(LVMI [m²]) Left Atrial Diameter (LAD [mm]) Blood Pressure (mmHg) Body Weight BMI Predialysis TnT postdialysis TnT proBNP Quality of Life

Source: https://euclinicaltrials.eu/ctis-public/view/2024-518591-31-00